EU clinical trial 2025-521188-11-00: EASi-PROTKT™ - A Phase III double-blind, randomised, parallel-group superiority trial to evaluate efficacy and safety of the combined use of oral vicadrostat (BI 690517) and empagliflozin compared with placebo and empagliflozin in participants with type 2 diabetes, hypertension and established cardiovascular disease
Protocol code: 1378-0041
Sponsor: Boehringer Ingelheim International GmbH, Boehringer Ingelheim Espana S.A. (Pharmaceutical company). Phase: Therapeutic confirmatory (Phase III). Countries: Lithuania (ongoing, recruiting), Netherlands (ongoing, recruiting), Ireland (ongoing, recruiting), Romania (ongoing, recruiting), France (ongoing, recruiting), Hungary (ongoing, recruiting), Finland (ongoing, recruiting), Latvia (ongoing, recruiting), Austria (ongoing, recruiting), Germany (ongoing, recruiting), Greece (ongoing, recruiting), Italy (ongoing, recruiting), Sweden (ongoing, recruiting), Denmark (ongoing, recruiting), Czechia (ongoing, recruiting), Belgium (ongoing, recruiting), Slovakia (ongoing, recruiting), Croatia (ongoing, recruiting), Spain (ongoing, recruiting), Norway (ongoing, recruiting), Bulgaria (authorised, recruiting), Poland (ongoing, recruiting), Portugal (ongoing, recruiting).
Therapeutic area(s): Diseases [C] - Cardiovascular Diseases [C14]
Gender: Female, Male. Age: 18-64 years, 65+ years. Enrolment: 4718.
Start date (EU): 2025-10-15. Decision date: 2025-09-24. Results received: No. Last updated: 2026-06-29.
Decision dates by country: AT: 2025-09-29, BE: 2025-11-06, BG: 2025-09-29, HR: 2025-09-29, CZ: 2025-09-25, DK: 2025-09-24, FI: 2025-09-26, FR: 2025-09-26, DE: 2025-09-26, GR: 2025-09-29, HU: 2025-09-29, IE: 2025-09-26, IT: 2025-09-29, LV: 2025-09-25, LT: 2025-09-29, PT: 2025-09-25, RO: 2025-09-29, ES: 2025-09-25, SE: 2025-09-25, NL: 2025-09-29, NO: 2025-09-26, PL: 2025-11-18, SK: 2025-09-24

Condition(s): Type 2 diabetes, cardiovascular disease, hypertension
Product: Placebo matching vicadrostat, Jardiance 10 mg film-coated tablets, BI 690517

Primary endpoint: Time to first event of CV death or HFE (defined as HHF or urgent HF visit)
Endpoint(s): Time to first event of CV death or HHF, Absolute change from baseline in mean SBP [mmHg] at Week 24, Relative change from baseline in UACR [mg/g] at Week 24, Time to first occurrence of the composite outcome of kidney disease progression, HHF, CV death, Time to first event of CV death, HFE, non-fatal MI or non-fatal stroke (4-point MACE), Occurrences of all-cause hospitalisations (first and recurrent), Time to first event of new-onset atrial fibrillation or atrial flutter (in participants without history of atrial fibrillation and atrial flutter) or CV death, Time to all-cause death, Time to CV death, Time to first HHF, Time to first event of new-onset HF or CV death, Occurrences of HHF (first and recurrent), Absolute change from baseline in mean DBP [mmHg] at Week 24

Source: https://euclinicaltrials.eu/ctis-public/view/2025-521188-11-00